EU clinical trial 2024-511988-29-01: Intracranial Injection of NK-92/5.28.z Cells in Combination With Intravenous Ezabenlimab in Patients With Recurrent HER2-positive Glioblastoma (CAR2BRAIN)
Protocol code: CAR2BRAIN
Sponsor: Goethe University Frankfurt (Educational Institution). Phase: Human Pharmacology (Phase I)- Other. Countries: Germany (ongoing, recruiting).
Therapeutic area(s): Diseases [C] - Nervous System Diseases [C10]
Gender: Female, Male. Age: 18-64 years, 65+ years. Enrolment: 42.
Status: Ongoing, recruiting. Start date (EU): 2017-11-08. Decision date: 2024-10-24. Results received: No. Last updated: 2026-07-09.

Condition(s): Glioblastoma

Source: https://euclinicaltrials.eu/ctis-public/view/2024-511988-29-01